EU clinical trial 2024-512679-11-00: Prospective, randomized, controlled, open, multicenter clinical trial on the efficacy and safety of materno-fetal hyperoxygenation (MFHO) during the third trimester of pregnancy to treat underdeveloped left ventricular structures of the fetus
Sponsor: Universitaetsklinikum Erlangen AöR (Hospital/Clinic/Other health care facility). Phase: Therapeutic confirmatory (Phase III). Countries: Germany (ongoing, recruiting).
Therapeutic area(s): Diseases [C] - Congenital, Hereditary, and Neonatal Diseases and Abnormalities [C16]
Gender: Female, Male. Age: In utero, 18-64 years. Enrolment: 64.
Status: Ongoing, recruiting. Start date (EU): 2025-04-25. Decision date: 2024-03-25. Results received: No. Last updated: 2026-07-09.

Condition(s): unborn baby with developmental disorder of the left side of the heart
Product: LOX medicAL 100% (V/V) Gas zur medizinischen Anwendung, kälteverflüssigt

Primary endpoint: median change of the sum of the Z-scores of the initially chosen echocardiographic fetal heart structures under O2 provocation at the time point PW35d0 (+/- 2 days) compared to the initial values on PW32d0 (+/- 2 days) under O2 provocation

Source: https://euclinicaltrials.eu/ctis-public/view/2024-512679-11-00